EU clinical trial 2024-510627-20-00: A Randomized Double-blind Placebo-controlled Phase 3 Study to Evaluate the Effect of Resmetirom on Liver-related Outcomes in Patients with Well-compensated (Child-Pugh A) Non alcoholic Steatohepatitis (NASH) Cirrhosis (MAESTRO-NASH OUTCOMES)
Protocol code: MGL-3196-19
Sponsor: Madrigal Pharmaceuticals Inc. (Pharmaceutical company). Phase: Therapeutic confirmatory (Phase III). Countries: Spain (ongoing, recruitment ended), Germany (ongoing, recruitment ended), France (ongoing, recruitment ended), Belgium (ongoing, recruitment ended), Italy (ongoing, recruitment ended).
Therapeutic area(s): Diseases [C] - Digestive System Diseases [C06]
Gender: Female, Male. Age: 18-64 years, 65+ years. Enrolment: 148.
Status: Ongoing, recruitment ended. Start date (EU): 2023-07-28. Decision date: 2024-07-17. Results received: No. Last updated: 2026-07-13.
Decision dates by country: BE: 2024-07-23, FR: 2024-07-18, DE: 2024-07-23, IT: 2024-07-24, ES: 2024-07-17

Condition(s): Non-alcoholic Steatohepatitis (NASH) Cirrhosis
Product: Matching placebo MGL-3196 100 mg film-coated tablet, MGL-3196 80 mg oral, MGL-3196 100 mg oral, MGL-3196 60 mg oral, Matching placebo MGL-3196 80 mg film-coated tablet, Matching placebo MGL-3196 60 mg film-coated tablet

Primary endpoint: The effect of once-daily, oral administration of resmetirom versus matching placebo on NASH CP-A patients, as measured by the time to a confirmed adjudicated CCO event. The CCO event is composed of all-cause mortality, liver transplant, significant hepatic events including hepatic decompensation events and confirmed increase of MELD score from <12 to ≥15.
Endpoint(s): 1. Percent change from baseline in LDL-C at Week 28 2. Percent change from Baseline to Week 52 in hepatic fat fraction by MRI-PDFF in patients with baseline MRI-PDFF >=5%.

Source: https://euclinicaltrials.eu/ctis-public/view/2024-510627-20-00